EU clinical trial 2023-506837-31-00: A 12-month, randomized, single-blind, placebo-controlled exposure-response study of TCD601 (siplizumab) in new onset type 1 diabetes patients (STRIDE)
Protocol code: TCD601F201
Sponsor: Itb-Med AB (Pharmaceutical company). Phase: Therapeutic exploratory (Phase II). Countries: Sweden (ended), Belgium (ended), Italy (ended), Spain (ended).
Therapeutic area(s): Diseases [C] - Nutritional and Metabolic Diseases [C18]; Diseases [C] - Hormonal diseases [C19]; Diseases [C] - Immune System Diseases [C20]
Gender: Female, Male. Age: 18-64 years. Enrolment: 113.
Status: Ended. Start date (EU): 2023-01-27. End date (EU): 2025-10-20. End date: 2025-10-21. Decision date: 2023-09-21. Results received: Yes. Last updated: 2025-03-24.
Decision dates by country: SE: 2023-09-21, ES: 2024-09-24, IT: 2024-11-21, BE: 2024-10-23

Condition(s): New onset type I diabetes
Product: Cetirizin Mylan 10 mg film-coated tablets, Paracetamol 500 mg Film Coated Tablets, 0,9% normal saline

Primary endpoint: Change from baseline in mean 4 hour stimulated C-Peptide AUC following a MMTT, compared to placebo at week 52.
Endpoint(s): Reported AEs/SAEs and AESIs (e.g., local, and systemic infections) graded per CTCAE criteria., • Change from baseline in: hemoglobin A1c (HbA1c); exogenous insulin usage •Incidence and severity of hypoglycemic episodes over time •Partial remission as measured by insulin dose adjusted HbA1c •Change in fasting and postprandial blood glucose concentrations by treatment arm •Incidence and severity of ketoacidosis. •CGM derived Ambulatory Glucose Profiles (AGPs) •4h MMTT C-peptide AUC and 2h MMTT C-peptide AUC •4h MMTT C-peptide peak concentration and percent of subjects with ≥0.2 pmol/mL, Incidence, Frequency, and severity of infection AEs/SAEs graded by CTCAE criteria, • Serial measurement of serum siplizumab concentrations. • Serial measurement of total lymphocyte counts, T-cells subsets over time, and siplizumab dose and serum concentrations.

Source: https://euclinicaltrials.eu/ctis-public/view/2023-506837-31-00